EU clinical trial 2024-517976-39-00: A multicentre clinical trial: Alveolar bone augmentation using MSCs and biphasic calcium phosphate granules prior to dental implants (Behandling Maxillofacial)
Sponsor: University of Bergen (Educational Institution). Phase: Phase II and Phase III (Integrated). Countries: Spain (ended), Norway (ended).
Therapeutic area(s): Diseases [C] - Musculoskeletal Diseases [C05]
Gender: Female, Male. Age: 18-64 years, 65+ years. Enrolment: 20.
Status: Ended. Start date (EU): 2018-07-01. End date (EU): 2025-03-06. Decision date: 2024-11-19. Results received: No. Last updated: 2024-11-19.
Decision dates by country: ES: 2024-11-19, NO: 2024-11-19

Condition(s): Alveolar bone augmentation in patient with bone defects in jaw with < than 4 mm in lateral width
Product: Mesenchymal stem cells

Primary endpoint: Principal assessment is linear change in bone width 2 mm below alveolar crest measured by means of CBCT images from baseline to 6 months after the regenerative surgery, immediately prior to implant placement.
Endpoint(s): Ability to place implants in the reconstructed area 6 months after the grafting procedure, Linear changes in mm measured with a gauge 2 mm below the alveolar crest, between the first surgery before applying the regenerative intervention and 6 months later at the second surgery, immediately before placing the implants, Adverse effects (AEs) and soft tissue healing (uneventful healing, wound dehiscence, membrane, exposure, redness, signs of infection, swelling) at 2 and 4 weeks and 6 months., Morbidity associated with procedures: o Number and type of postoperative anti-inflammatory medication o The degree of reported pain using a VAS scale., Patient’s satisfaction: - Patient reported outcomes (PROMs) using a structured questionnaire with Likert scales. - Patient’s overall quality of life (QoL) will be assessed with the use of validated tools: Health-related Quality of Life (HRQoL) and Oral Health-Related Quality of Life (OHRQoL)., Fate of the transplanted MSCs by liquid biopsy technology (screening, and 2 weeks after the bone augmentation) surgery by collecting peripheral blood samples and plasma/sera), Bone promoting activity of the intervention by evaluating the core biopsies harvested during re-entry procedure at the sites receiving dental implant by micro-computed tomography (μCT) and histology, The need of secondary bone augmentation around the dental implants placed in correct prosthetic driven position, Implant stability at time of implant installation, at abutment surgery, at loading, and 12 months after loading (using Osstell® radiofrequency implant stability quotients)., Evaluate local conditions, hygiene and absence of inflammation

Source: https://euclinicaltrials.eu/ctis-public/view/2024-517976-39-00